EU clinical trial 2023-506054-20-00: A Phase III, Randomized, Double-Blind, Placebo-Controlled, Multicenter, Global Study of Rilvegostomig in Combination With Chemotherapy as Adjuvant Treatment After Resection of Biliary Tract Cancer With Curative Intent (ARTEMIDE-Biliary01)
Protocol code: D7025C00001
Sponsor: Astrazeneca AB (Pharmaceutical company). Phase: Therapeutic confirmatory (Phase III). Countries: Norway (ongoing, recruitment ended), Italy (ongoing, recruitment ended), Poland (ongoing, recruitment ended), Spain (ongoing, recruitment ended), Belgium (ongoing, recruitment ended), Denmark (ongoing, recruitment ended), France (ongoing, recruitment ended), Germany (ongoing, recruitment ended).
Therapeutic area(s): Diseases [C] - Neoplasms [C04]
Gender: Female, Male. Age: 18-64 years, 65+ years. Enrolment: 182.
Status: Ongoing, recruitment ended. Start date (EU): 2024-06-05. Decision date: 2024-05-03. Results received: No. Last updated: 2026-06-23.
Decision dates by country: IT: 2024-05-07, DE: 2024-08-02, ES: 2024-05-09, BE: 2024-08-06, PL: 2024-05-07, NO: 2024-05-03, FR: 2024-08-13, DK: 2024-08-03

Condition(s): Adenocarcinoma of the biliary tract (intrahepatic or extrahepatic cholangiocarcinoma or muscle invasive gallbladder cancer GBC)
Product: CISPLATIN, TEGAFUR, INFLIXIMAB, GLUCOSE, TEGAFUR, GEMCITABINE, CAPECITABINE, Rilvegostomig, CAPECITABINE, SODIUM CHLORIDE, MYCOPHENOLATE MOFETIL

Primary endpoint: Recurrence free survival (RFS) for Arm A vs. Arm B
Endpoint(s): Overall Survival (OS) for Arm A vs. Arm B, Patient-reported tolerability Arm A vs. Arm B, Progression Free Survival (PFS) following recurrence Arm A vs. Arm B

Source: https://euclinicaltrials.eu/ctis-public/view/2023-506054-20-00